EU clinical trial 2024-511227-33-00: PHASE Ib STUDY WITH THE COMBINATION OF LB−100 (PP2A INHIBITOR) AND AZENOSERTIB (WEE1 INHIBITOR) IN PATIENTS WITH METASTATIC COLORECTAL CANCER The COLLEE trial
Protocol code: N23LAC
Sponsor: Het Nederlands Kanker Instituut-Antoni van Leeuwenhoek Ziekenhuis Stichting (Hospital/Clinic/Other health care facility). Phase: Human Pharmacology (Phase I)- Other. Countries: Netherlands (suspended).
Therapeutic area(s): Diseases [C] - Neoplasms [C04]
Gender: Female, Male. Age: 18-64 years, 65+ years. Enrolment: 43.
Status: Suspended. Decision date: 2024-06-28. Results received: No. Last updated: 2024-11-08.

Condition(s): Metastatic colorectal cancer
Product: azenosertib, also known as ZN-c3

Primary endpoint: The endpoint will be the incidence of DLTs.
Endpoint(s): To characterise the safety and tolerability of LB−100 and azenosertib. The endpoint is the incidence and severity of AEs and DLTs., To determine the efficacy of the combination LB−100 and azenosertib. The endpoints are the DCR, ORR, PFS, OS and DoR.

Source: https://euclinicaltrials.eu/ctis-public/view/2024-511227-33-00